EU clinical trial 2025-523914-10-00: Evaluating the clinical effectiveness of sodium bicarbonate for critically ill patients with metabolic acidosis and acute kidney injury
Protocol code: UniMs23_0017
Sponsor: Universitaet Muenster (Educational Institution). Phase: Therapeutic use (Phase IV). Countries: Germany (ongoing, recruiting).
Therapeutic area(s): Analytical, Diagnostic and Therapeutic Techniques and Equipment [E] - Therapeutics [E02]; Diseases [C] - Nutritional and Metabolic Diseases [C18]
Gender: Female, Male. Age: 18-64 years, 65+ years. Enrolment: 660.
Status: Ongoing, recruiting. Start date (EU): 2026-04-30. Decision date: 2026-03-17. Results received: No. Last updated: 2026-07-08.

Condition(s): Acute kidney injury, Critical illness, Metabolic acidosis
Product: Elektrolyt-Infusionslösung 153; Gesamtkationen/-anionen 153 mval/l, Infusionslösung zur intravenösen Anwendung, Sterofundin ISO Infusionslösung, SODIUM HYDROGEN CARBONATE, Jonosteril Infusionslösung, Ringer-Infusionslösung B. Braun

Primary endpoint: Major adverse kidney events (MAKE90) Binary endpoint consisting of mortality or any KRT within 90 days after randomization or persistent renal dysfunction (creatinine value at day 90 ≥200% of baseline value) at day 90
Endpoint(s): 90-day all-cause mortality (%), Elevation of the creatinine level to ≥200% of baseline value at day 90 (one measurement between day 80 and 120 after randomization), Receipt of any form of KRT within the 90-day time period after randomization, Kidney Replacement Therapy (KRT)-dependence at day 90 after randomization, KRT-free days, defined as difference between number of days alive and number of days receiving KRT of any form between randomization and day 90

Source: https://euclinicaltrials.eu/ctis-public/view/2025-523914-10-00